EU clinical trial 2022-503019-40-00: A Randomized, Double-blind, Double Placebo-controlled, 4-Period Crossover Study to Evaluate the Central Nervous System Pharmacodynamic Activity of Brexanolone Using Transcranial Magnetic Stimulation in Healthy Male Participants
Protocol code: 547-TRM-101
Sponsor: Sage Therapeutics Inc. (Pharmaceutical company). Phase: Human Pharmacology (Phase I)- Other. Countries: Netherlands (ended).
Therapeutic area(s): Analytical, Diagnostic and Therapeutic Techniques and Equipment [E] - Investigative Techniques [E05]
Gender: Male. Age: 18-64 years. Enrolment: 24.
Status: Ended. Start date (EU): 2023-05-11. End date (EU): 2023-10-09. Decision date: 2023-04-28. Results received: Yes. Last updated: 2023-05-12.
Decision dates by country: NL: 2023-05-12

Condition(s): NA, PD study in Healthy Volunteers
Product: Lorazepam Aurobindo 1 mg, tabletten, Lorazepam placebo, BREXANOLONE, Brexanolone placebo

Primary endpoint: Change from baseline in TMS-MEPs amplitude obtained from single-pulse TMS-electromyography at T1
Endpoint(s): Change from baseline in magnitude of short-interval cortical inhibition obtained with paired-pulse TMS-electromyography at T1, Change from baseline in magnitude of intracortical facilitation (ICF) obtained with paired pulse TMS-electromyography at T1, Change from baseline in magnitude of long-interval cortical inhibition obtained with paired-pulse TMS-electromyography at T1

Source: https://euclinicaltrials.eu/ctis-public/view/2022-503019-40-00